EU clinical trial 2024-510971-39-00: A Single-Ascending-Dose Study of MK6916 in Healthy Participants
Protocol code: MK-6916-001
Sponsor: Merck Sharp & Dohme LLC (Pharmaceutical company). Phase: Human Pharmacology (Phase I)- First administration to humans. Countries: Belgium (ended).
Therapeutic area(s): Diseases [C] - Nervous System Diseases [C10]
Gender: Male. Age: 18-64 years. Enrolment: 16.
Status: Ended. Start date (EU): 2024-05-03. End date (EU): 2024-09-25. End date: 2024-09-26. Decision date: 2024-04-25. Results received: No. Last updated: 2024-04-25.

Condition(s): Acute and chronic Pain

Source: https://euclinicaltrials.eu/ctis-public/view/2024-510971-39-00